EU clinical trial 2024-518226-32-00: Reward-specific changes of cerebral dopamine synthesis in healthy volunteers and depressed patients
Protocol code: 18F-FDOPA-BUP
Sponsor: Medical University Of Vienna (Educational Institution). Phase: Therapeutic use (Phase IV). Countries: Austria (ongoing, recruiting).
Therapeutic area(s): Psychiatry and Psychology [F] - Mental Disorders [F03]
Gender: Female, Male. Age: 18-64 years, 65+ years. Enrolment: 100.
Status: Ongoing, recruiting. Start date (EU): 2023-01-05. Decision date: 2025-01-15. Results received: No. Last updated: 2026-07-08.

Condition(s): Major Depression
Product: Wellbutrin XR 150 mg-Retardtabletten, Cipralex® 10 mg – Filmtabletten

Primary endpoint: Reward-specific changes of dopamin-synthesis
Endpoint(s): To analyze the relationship between reward-specific dopamine synthesis and fMRI activation across healthy volunteers and patients with MDD, To identify remission rates in MDD patients being treated with either escitalopram OR bupropion in a longitudinal design, Test-retest reliability for the quantification of dopamine synthesis rates in healthy volunteers

Source: https://euclinicaltrials.eu/ctis-public/view/2024-518226-32-00